EU clinical trial 2025-520972-24-00: Exploring the anti-aging effects of Metformin in COPD
Sponsor: Fundacion Instituto De Investigacion Sanitaria De Navarra (Laboratory/Research/Testing facility). Phase: Therapeutic confirmatory (Phase III). Countries: Spain (ongoing, recruiting).
Therapeutic area(s): Diseases [C] - Respiratory Tract Diseases [C08]
Gender: Female, Male. Age: 18-64 years, 65+ years. Enrolment: 212.
Status: Ongoing, recruiting. Start date (EU): 2026-04-08. Decision date: 2025-11-12. Results received: No. Last updated: 2026-08-06.

Condition(s): Chronic Obstructive Pulmonary Disease (COPD)
Product: Metformina Uxa 850 mg comprimidos recubiertos con película EFG, El producto denominado Placebo Metformina comprimidos recubiertos está constituido por comprimidos recubiertos blancos que contienen celulosa microcristalina Ph Eur, acondicionados en blisters de PVC/PE/PVDC transparente con aluminio anónimo.

Primary endpoint: Change in FEV1 at baseline and 3-year follow-up.
Endpoint(s): Age, Sex at birth, Height, Baseline weight and annually until the end of follow-up., Baseline smoking status., Blood tests at baseline and annually until the end of follow-up., Urinalysis with baseline renal function and annually until the end of follow-up., Baseline and 3-year microbiota analysis., Percentage of lung volume affected with emphysema at baseline and 3-year follow-up., COPD assessment test (CAT), baseline and every 6 months until the end of follow-up., mMRC scale at baseline and annually until the end of follow-up., Number of annual exacerbations, doctor visits, hospitalisations., BODE index at baseline and annually until the end of follow-up., 6 minutes walking test (6MWD) at baseline and annually until the end of follow-up., Hand grip strength of the dominant hand baseline and annually until the end of follow-up., Incidence of lung cancer and other solid tumours throughout follow-up., Incidence of myocardial infarction, new angina, stroke, renal failure throughout follow-up.

Source: https://euclinicaltrials.eu/ctis-public/view/2025-520972-24-00